EU clinical trial 2023-509070-36-00: A Two-Part Multicenter, Double-Blind, Randomized Placebo-Controlled Study to Evaluate Efficacy and Safety and the Maintenance of Effect of 20-mg Seltorexant as Adjunctive Therapy to Antidepressants in Adult and Elderly Patients with Major Depressive Disorder with Insomnia Symptoms
Protocol code: 42847922MDD3003
Sponsor: Janssen Cilag International (Pharmaceutical company). Phase: Therapeutic confirmatory (Phase III). Countries: Poland (ongoing, recruiting), Bulgaria (ongoing, recruiting), Romania (ongoing, recruiting), Czechia (ongoing, recruiting), Italy (ongoing, recruiting), Spain (ongoing, recruiting), Sweden (ongoing, recruiting), Portugal (ongoing, recruiting), Slovakia (ongoing, recruiting).
Therapeutic area(s): Psychiatry and Psychology [F] - Mental Disorders [F03]
Gender: Female, Male. Age: 18-64 years, 65+ years. Enrolment: 202.
Status: Ongoing, recruiting. Start date (EU): 2025-03-18. Decision date: 2025-03-03. Results received: No. Last updated: 2026-07-14.
Decision dates by country: SK: 2025-03-04, BG: 2025-03-07, ES: 2025-03-05, PL: 2025-03-09, IT: 2025-03-06, PT: 2025-03-03, SE: 2025-03-03, CZ: 2025-03-05, RO: 2025-03-10

Condition(s): Major Depressive Disorder with Insomnia Symptoms
Product: Placebo Film-coated tablet, JNJ-42847922

Primary endpoint: Part 1 (Efficacy): Change from baseline to Day 43 in the MADRS total score., Part 2 Time from randomization to the first relapse during the double-blind (DB) Maintenance Phase in participants who achieve a stable response at the end of open-label (OL) seltorexant treatment

Source: https://euclinicaltrials.eu/ctis-public/view/2023-509070-36-00